EU clinical trial 2022-503114-23-00: A Phase 1b/2, Open-Label Umbrella Study to Evaluate Safety and Efficacy of Elacestrant in Various Combinations in Patients with Metastatic Breast Cancer (ELEVATE)
Protocol code: STML-ELA-0222
Sponsor: Stemline Therapeutics Inc. (Pharmaceutical company). Phase: Human Pharmacology (Phase I)- Other. Countries: Poland (ended), Hungary (ended), Germany (ended), France (ongoing, recruitment ended), Czechia (ended), Spain (ongoing, recruitment ended), Italy (ongoing, recruitment ended), Belgium (ongoing, recruitment ended).
Therapeutic area(s): Diseases [C] - Neoplasms [C04]
Gender: Female, Male. Age: 18-64 years, 65+ years. Enrolment: 320.
Start date (EU): 2023-12-19. Decision date: 2023-10-20. Results received: No. Last updated: 2026-03-13.
Decision dates by country: FR: 2024-02-23, BE: 2023-10-23, CZ: 2023-10-24, DE: 2023-10-20, HU: 2023-10-25, PL: 2023-10-23, ES: 2023-10-30, IT: 2023-10-25

Condition(s): Breast Cancer

Source: https://euclinicaltrials.eu/ctis-public/view/2022-503114-23-00